EU clinical trial 2023-509229-31-00: A Phase 3 Open-Label Study of PTC923 (Sepiapterin) in Phenylketonuria
Protocol code: PTC923-MD-004-PKU
Sponsor: PTC Therapeutics Inc. (Pharmaceutical company). Phase: Therapeutic confirmatory (Phase III). Countries: Netherlands (ended), Germany (ended), Spain (ended), Italy (ended), Denmark (ended), Portugal (ended), Poland (ended), Czechia (ended), France (ended), Slovenia (ended).
Therapeutic area(s): Phenomena and Processes [G] - Metabolism [G03]
Gender: Female, Male. Age: 0-17 years, 18-64 years, 65+ years. Enrolment: 80.
Status: Ended. Start date (EU): 2022-09-28. End date (EU): 2026-07-09. End date: 2026-07-21. Decision date: 2024-02-02. Results received: No. Last updated: 2026-05-22.
Decision dates by country: PT: 2024-02-05, IT: 2024-02-12, ES: 2024-02-05, DE: 2024-02-05, PL: 2024-11-11, NL: 2024-02-02, DK: 2024-02-02, CZ: 2024-10-24, FR: 2024-10-18, SI: 2024-10-01

Condition(s): Metabolic Disorders - Phenylketonuria
Product: PTC923, PTC923

Primary endpoint: Safety of long-term treatment with PTC923 will be measured by number of treatment-emergent adverse events (TEAEs), including assessment of severity of TEAEs, clinical laboratory tests, vital signs, and physical examinations., The primary efficacy endpoint is the change from baseline in dietary Phe/protein consumption measured during Dietary Phe Tolerance Assessment period.
Endpoint(s): Changes from baseline in QOL using PKU-QOL questionnaire in the subset of subjects who are able to complete the PKU-QOL (ie, subjects whose primary language is English [British or American], Turkish, Dutch, German, Spanish, Italian, Portuguese, or French) (ages 6 to 8 years Parent PKU-QOL; ages 9 to 11 years Child PKU-QOL; ages 12 to 17 years Adolescent PKU-QOL; ages ≥18 years Adult PKU-QOL), Changes from baseline in QOL using the EQ-5D (EQ-5D-Y Proxy Version 1 [3 to 7 years]; EQ-5D-Y [8 to 15 years]; EQ-5D-5L ([≥16 years]), PK assessment of sepiapterin and BH4 concentrations in plasma following dosing of sepiapterin, Acceptability scores (<12 years); taste and palatability scores (<18 years)

Source: https://euclinicaltrials.eu/ctis-public/view/2023-509229-31-00